EU clinical trial 2023-506597-12-00: MOODBOOSTER« Early efficacy of ketamine compared to placebo, in add-on therapy of venlafaxine for inpatients with severe unipolar major depressive episodes: a double blind randomized controlled trial »
Protocol code: APHP220668
Sponsor: Assistance Publique Hopitaux De Paris (Hospital/Clinic/Other health care facility). Phase: Therapeutic confirmatory (Phase III). Countries: France (ongoing, recruiting).
Therapeutic area(s): Psychiatry and Psychology [F] - Mental Disorders [F03]
Gender: Female, Male. Age: 18-64 years. Enrolment: 60.
Status: Ongoing, recruiting. Start date (EU): 2024-11-20. Decision date: 2024-06-27. Results received: No. Last updated: 2026-08-04.

Condition(s): Major depressive disorder with current severe major depressive episode
Product: 11C-UCB-J, VENLAFAXINE, KETAMINE, CHLORURE DE SODIUM 0,9% RENAUDIN, solution injectable

Primary endpoint: Total score change of the Hamilton Depression Rating Scale (HDRS 17 items: scale items are rated from 0 to 2 or from 0 to 4 and the score ranges from 0 to 52) after 7 days of treatment
Endpoint(s): 1 et 4) Efficacy: assessed by 5 complementary criteria a) main criteria : Total score change of the Hamilton Depression Rating Scale (HDRS 17) b) response rate : ≥50% HDRS total score improvement c) remission : (HDRS 17 items ≤ 7) d) Beck Depression Inventory (BDI) change e) Clinical Global Impression rating scale (CGI), 2) hospital stay length ( the number of days spent in hospital, including re-hospitalization, during the fallow up 42 days). The end of the hospital stay is decided by the clinician blinded to treatment., 3) Total scores change on the Columbia Suicide Risk Scale (C-SSRS), 5) The safety assessed with Common Terminology Criteria for Adverse Events (CTCAE) Version 5.0. The occurrence of adverse effects in the ketamine and placebo groups will be assessed by monitoring during the infusion of treatment or placebo and up to 40 minutes afterwards blood pressure, heart rate, respiratory rate, nausea/vomiting, dissociation, headache., 6) cumulative consumption in mg of cyamemazine over the entire study period, 7) biomarkers predictive or associated with the efficacy of ketamine on add on to venlafaxine

Source: https://euclinicaltrials.eu/ctis-public/view/2023-506597-12-00